EU clinical trial 2022-502664-21-00: Noisy Rebels; Non-inferiority study of rituximab compared to ocrelizumab in relapsing MS
Sponsor: Amsterdam UMC (Hospital/Clinic/Other health care facility). Phase: Therapeutic use (Phase IV). Countries: Netherlands (ongoing, recruitment ended).
Therapeutic area(s): Diseases [C] - Nervous System Diseases [C10]
Gender: Female, Male. Age: 18-64 years. Enrolment: 200.
Status: Ongoing, recruitment ended. Start date (EU): 2023-05-01. Decision date: 2023-03-03. Results received: No. Last updated: 2026-04-13.

Condition(s): multiple sclerosis
Product: Rixathon 100 mg concentrate for solution for infusion, MabThera 100 mg concentrate for solution for infusion, Rixathon 100 mg concentrate for solution for infusion, Rixathon 100 mg concentrate for solution for infusion, MabThera 500 mg concentrate for solution for infusion, Truxima 100 mg concentrate for solution for infusion, Truxima 500 mg concentrate for solution for infusion, Rixathon 500 mg concentrate for solution for infusion, Ruxience 500 mg concentrate for solution for infusion, Ocrevus 300 mg concentrate for solution for infusion, Ocrevus 300 mg concentrate for solution for infusion, Ruxience 100 mg concentrate for solution for infusion, Rixathon 500 mg concentrate for solution for infusion

Primary endpoint: • The proportion of patients with no new or enlarged T2 lesions on brain MRI between month 6 and month 24 of treatment in each arm.
Endpoint(s): • The annual relapse rate between baseline to month 24 • The annual relapse rate between month 6 to month 24 • Proportion of patients with no relapses from baseline to month 24 • Proportion of patients with no relapses from month 6 to month 24 • Time to first relapse • Proportion of patients with no contrast enhancing lesions between baseline and month 24 • Proportion of patients with no contrast enhancing lesions between month 6 and month 24 • The average number of new/enlarged T2 lesions betwe

Source: https://euclinicaltrials.eu/ctis-public/view/2022-502664-21-00